EU clinical trial 2025-524625-41-00: Effects of bempedoic acid/ezetimibe/high-intensity statin on plaque regression and stabilisation of coronary atherosclerosis among patients without cardiovascular events
Protocol code: DSE-BMP-0005-CIS-MA
Sponsor: Daiichi Sankyo Europe GmbH (Pharmaceutical company). Phase: Therapeutic confirmatory (Phase III). Countries: Italy (authorised, recruitment pending), Spain (authorised, recruiting), Germany (authorised, recruitment pending).
Therapeutic area(s): Diseases [C] - Cardiovascular Diseases [C14]
Gender: Female, Male. Age: 18-64 years, 65+ years. Enrolment: 103.
Start date (EU): 2026-07-17. Decision date: 2026-06-22. Results received: No. Last updated: 2026-08-06.
Decision dates by country: IT: 2026-06-30, ES: 2026-06-24, DE: 2026-08-06

Condition(s): Coronary atherosclerosis
Product: BEMPEDOIC ACID AND EZETIMIBE, ATORVASTATIN, ROSUVASTATIN

Primary endpoint: Annualised change in percentage plaque burden (Δ%PB) at End of Treatment (EoT)
Endpoint(s): Annualised change in normalised non-calcified PV at EoT (in mm3)., Percentage of participants with regression in normalised TPV, normalised non-calcified PV, and normalised low attenuation PV at EoT (i.e., ΔPV and Δnon-calcified PV, and Δlow-attenuation PV)., Change in the absolute Agatston coronary artery calcium (CAC) score at EoT., Relationship between the annualised change in LDL-C and the Δ%PB and Δ% non-calcified PB at EoT, as visualised by locally estimated scatterplot smoothing (LOESS) plot., Annualised ΔTPV (in mm3) at EoT., Percentage of participants with regression in TPV (i.e., negative ΔTPV) at EoT., • Absolute annualised change in fractional flow reserve derived from computed tomography (FFRCT) of the vessel with the lowest FFR at Baseline. • Absolute annualised change in FFRCT of the average of 3 main epicardial coronary arteries (left anterior descending artery [LAD], circumflex artery [Cx], right coronary artery [RCA])., Mean absolute changes in atherosclerosis-related biomarkers after 3 and 6 months and at EoT: total cholesterol, LDL-C, high-density lipoprotein cholesterol (HDL-C), non-HDL-C, triglycerides, lipoprotein (a) (Lp(a)), apolipoprotein B (apoB), and high-sensitive C reactive protein (hs-CRP)., Annualised changes in Framingham steatosis index (FSI) and fibrosis-4 (Fib-4), Cumulative incidence of AEs under triple therapy during the trial., The rate of treatment discontinuation and the reasons for treatment discontinuation during the trial.

Source: https://euclinicaltrials.eu/ctis-public/view/2025-524625-41-00